EU clinical trial 2023-508324-35-00: A randomized, double-blind, placebo-controlled, multicenter trial assessing the reduction of the rate of lipoprotein apheresis after treatment with pelacarsen (TQJ230) compared to placebo in patients with hyperlipoproteinemia(a) and established cardiovascular disease undergoing weekly lipoprotein apheresis in Germany
Protocol code: CTQJ230A12302
Sponsor: Novartis Pharma AG (Pharmaceutical company). Phase: Therapeutic confirmatory (Phase III). Countries: Germany (ended).
Therapeutic area(s): Diseases [C] - Cardiovascular Diseases [C14]
Gender: Female, Male. Age: 18-64 years, 65+ years. Enrolment: 51.
Status: Ended. Start date (EU): 2022-08-19. End date (EU): 2025-01-28. End date: 2025-01-29. Decision date: 2024-04-24. Results received: Yes. Last updated: 2024-12-04.

Condition(s): Apheresis
Product: TQJ230, Placebo to TQJ230 80 mg/0.8 mL Solution for injection in pre-filled syringe with needle safety device

Primary endpoint: Rate of lipoprotein apheresis sessions performed over 52 weeks normalized to the weekly lipoprotein apheresis schedule
Endpoint(s): Time to lipoprotein apheresis avoidance (where lipoprotein apheresis avoidance is defined as at least 24 weeks of no lipoprotein apheresis until end of study), Total avoidance of lipoprotein apheresis from week 12 to week 52, Change from baseline to week 52 in the log-transformed Lp(a) (measured prior to planned lipoprotein apheresis)

Source: https://euclinicaltrials.eu/ctis-public/view/2023-508324-35-00